EU clinical trial 2022-500545-24-00: C4891002: A Phase 3, Randomized, Open-Label, Multicenter Study Of Vepdegestrant (ARV-471- PF-07850327) Plus Palbociclib Versus Letrozole Plus Palbociclib For The Treatment Of Participants With Estrogen Receptor Positive, HER2-Negative Breast Cancer Who Have Not Received Any Prior Systemic Anti-Cancer Treatment For Advanced Disease (VERITAC-3)
Protocol code: C4891002
Sponsor: Pfizer Inc. (Pharmaceutical company). Phase: Therapeutic confirmatory (Phase III). Countries: Slovakia (ongoing, recruitment ended), Spain (ongoing, recruitment ended), Italy (ongoing, recruitment ended), Hungary (ongoing, recruitment ended).
Therapeutic area(s): Diseases [C] - Neoplasms [C04]; Diseases [C] - Hormonal diseases [C19]
Gender: Female, Male. Age: 18-64 years, 65+ years. Enrolment: 17.
Status: Ongoing, recruitment ended. Start date (EU): 2023-10-04. Decision date: 2023-09-19. Results received: No. Last updated: 2026-06-11.
Decision dates by country: ES: 2023-09-22, HU: 2023-09-25, SK: 2023-09-19, IT: 2023-09-22

Condition(s): ER + /HER 2 - Advanced Breast Cancer
Product: PF-07850327 round, palbociclib, IBRANCE 100 mg hard capsules, IBRANCE 75 mg hard capsules

Primary endpoint: Study Lead-in: •Incidence of Grade 4 neutropenia AE (as graded by NCI CTCAE v5.0) with onset within the first 4 cycles. •Incidence of dose reduction or drug discontinuation within the first 4 cycles., Phase 3: •Progression-free survival (PFS), defined as the time from the date of randomization to the date of first documented disease progression, as determined by BICR assessment per RECIST v1.1, or death due to any cause, whichever occurs first.
Endpoint(s): Study Lead-in: •Incidence of AEs and SAEs •Incidence of laboratory abnormalities. •Incidence of ECG abnormalities., Study Lead-in: •Objective Response, Clinical Benefit Response, Duration of response as determined by investigator assessment per RECIST v1.1, Study Lead-in: •Plasma concentrations of vepdegestrant and ARV-473., Study Lead-in: •Plasma concentrations of palbociclib., Phase 3: •Overall Survival (OS), defined as the time from the date of randomization to the date of death due to any cause., Phase 3: •Objective Response, clinical Benefit Response, duration of response as determined by BICR assessment per RECIST v 1.1, Phase 3: •Incidence of AEs and SAEs • Incidence of laboratory abnormalities. •Incidence of ECG abnormalities., Phase 3: •Plasma concentrations of vepdegestrant and its epimer ARV-473., Phase 3: •Plasma concentrations of palbociclib., Phase 3: • EuroQol EQ-5D-5L •EORTC QLQ-C30 •EORTC QLQ-BR23, Phase 3: •ctDNA plasma quantitative changes from pretreatment to evaluate potential predictability of their associations with clinical outcomes.

Source: https://euclinicaltrials.eu/ctis-public/view/2022-500545-24-00